EU clinical trial 2022-502409-14-00: Initiation of angiotensin receptor-neprilysin inhibitor (ARNi) and sodium-glucose cotransporter-2 inhibitors (SGLT2i) in patients with heart failure with reduced ejection fraction (HFrEF): the INITIATE-HFrEF randomized open-label trial
Protocol code: INITIATE-HFrEF
Sponsor: University Of Porto (Educational Institution). Phase: Phase III and phase IV (Integrated). Countries: Portugal (ended).
Therapeutic area(s): Diseases [C] - Cardiovascular Diseases [C14]
Gender: Female, Male. Age: 18-64 years, 65+ years. Enrolment: 172.
Status: Ended. Start date (EU): 2023-08-04. End date (EU): 2025-07-31. Decision date: 2023-04-12. Results received: Yes. Last updated: 2025-05-27.

Condition(s): Heart failure with reduced ejection fraction
Product: LINAGLIPTIN AND EMPAGLIFLOZIN, VALSARTAN AND SACUBITRIL, EMPAGLIFLOZIN, METFORMIN AND DAPAGLIFLOZIN, DAPAGLIFLOZIN, SAXAGLIPTIN AND DAPAGLIFLOZIN, METFORMIN AND EMPAGLIFLOZIN

Primary endpoint: Composite outcome (time-to-first event’ occurrence during the 6 months of follow-up): Symptomatic hypotension; Hyperkalaemia; Hypokalemia; eGFR drop ≥50% from baseline; or eGFR <15 ml/min/1.73m2 or renal transplant or dialysis; Increase in diuretic dose due to worsening HF; Use of intravenous diuretics for worsening HF; HF hospitalization; Death from CV causes
Endpoint(s): Symptomatic hypotension (systolic blood pressure <100 mmHg with signs or symptoms compatible with hypoperfusion), Hyperkalaemia (serum potassium >6.0 mmol/L), Hypokalemia (serum potassium <3.0 mmol/L), eGFR drop ≥50% from baseline; or eGFR <15 ml/min/1.73m2 or renal transplant or dialysis, Increase in diuretic dose due to worsening heart failure, Use of intravenous diuretics for worsening heart failure, Heart failure hospitalization, Death from cardiovascular causes, NT-pro BNP or BNP (log), High sensitivity C-reactive protein, Atrial fibrillation/flutter, Systolic and diastolic blood pressure, High sensitivity Troponin, Left atrial volume, Left ventricular (LV) systolic and diastolic volume, LV mass, LV ejection fraction, Pulmonary artery systolic pressure, Serum sodium, Serum potassium, Creatinine and glomerular filtration rate, Urinary sodium and potassium and albuminuria, Total Cholesterol, LDL Cholesterol, HDL Cholesterol, Triglycerides, Glucose and HbA1C, Uric acid, TSH and free T4, ALT, AST, Gamma-GT, Alkaline Phosphatase, Bilirubin, Iron, Ferritin and Sat. transferrin, Functional class (NYHA, New York Heart Association), Quality of life (KCCQ, Kansas City Cardiomyopathy Questionnaire), Dosage titration of sacubitril/valsartan up to the dose 97/103 mg (b.i.d.) at 3 months

Source: https://euclinicaltrials.eu/ctis-public/view/2022-502409-14-00